EU clinical trial 2024-512158-12-00: A Phase 3, Randomized, Study of Neoadjuvant Chemotherapy alone versus Neoadjuvant Chemotherapy plus Nivolumab or Nivolumab and BMS- 986205, Followed by Continued Post- Surgery Therapy with Nivolumab or Nivolumab and BMS-986205 in Participants with Muscle-Invasive Bladder Cancer
Protocol code: CA017-078
Sponsor: Bristol-Myers Squibb Services Unlimited Company (Pharmaceutical company). Phase: Therapeutic confirmatory (Phase III). Countries: Germany (ended), Norway (ended), France (ended), Finland (ended), Romania (ended), Austria (ended), Spain (ended), Netherlands (ended), Belgium (ended), Italy (ended), Greece (ended).
Therapeutic area(s): Diseases [C] - Neoplasms [C04]
Gender: Female, Male. Age: 18-64 years, 65+ years. Enrolment: 386.
Status: Ended. Start date (EU): 2018-12-14. End date (EU): 2026-04-06. End date: 2026-04-15. Decision date: 2024-06-05. Results received: No. Last updated: 2026-04-14.
Decision dates by country: ES: 2024-06-10, DE: 2024-06-06, FI: 2024-06-07, NL: 2024-06-06, AT: 2024-06-09, IT: 2024-06-18, NO: 2024-06-06, FR: 2024-06-05, GR: 2024-07-22, RO: 2024-06-07, BE: 2024-06-05

Condition(s): Bladder Cancer Muscle-Invasive Bladder Cancer
Product: CISPLATIN-EBEWE, 1 MG/ML, KONCENTRAT DO SPORZĄDZANIA ROZTWORU DO INFUZJI, Cisplatin NeoCorp 1 mg/ml - Konzentrat zur Herstellung einer Infusionslösung, OPDIVO 10 mg/mL concentrate for solution for infusion., Cisplatin Teva® 1 mg/ml Konzentrat zur Herstellung einer Infusionslösung, GEMSOL, 40 MG/ML, KONCENTRAT DO SPORZĄDZANIA ROZTWORU DO INFUZJI

Primary endpoint: Pathological Complete Response (pCR) rate of neoadjuvent Chemo Alone, Pathological Complete Response (pCR) rate of neoadjuvant Nivo + Chemo, Event-Free Survival (EFS) of SOC Chemo after RC, Event-Free Survival (EFS) of neoadjuvant Nivo + Chemo followed by continued Nivo after RC
Endpoint(s): Overall Survival (OS), Incidence of Adverse Events (AE), Incidence of Serious Adverse Events (SAE), Incidence of Laboratory abnormalities, pCR rate, EFS, and OS as defined

Source: https://euclinicaltrials.eu/ctis-public/view/2024-512158-12-00